EU clinical trial 2023-510196-59-00: A Phase 3, open-label, randomized, controlled study to evaluate the immune response, safety and reactogenicity of RSVPreF3 OA investigational vaccine when co-administered with a COVID-19 mRNA vaccine (Omicron XBB.1.5) in adults aged 50 years and above.
Protocol code: 217848
Sponsor: GlaxoSmithKline Biologicals (Pharmaceutical company). Phase: Therapeutic confirmatory (Phase III). Countries: Spain (ended), Belgium (ended), Netherlands (ended).
Therapeutic area(s): Diseases [C] - Virus Diseases [C02]
Gender: Female, Male. Age: 18-64 years, 65+ years. Enrolment: 600.
Status: Ended. Start date (EU): 2024-06-15. End date (EU): 2025-04-18. End date: 2025-04-19. Decision date: 2024-06-03. Results received: Yes. Last updated: 2025-04-08.
Decision dates by country: BE: 2024-06-03, ES: 2024-06-03, NL: 2024-06-03

Condition(s): Respiratory Syncytial Virus Infections
Product: Arexvy powder and suspension for suspension for injection Respiratory Syncytial Virus (RSV) vaccine (recombinant, adjuvanted), Comirnaty Omicron XBB.1.5 30 micrograms/dose dispersion for injection COVID-19 mRNA Vaccine

Primary endpoint: • RSV-A neutralization titers expressed as group GMT ratio 1 month after the RSVPreF3 OA investigational vaccine dose. • RSV-B neutralization titers expressed as group GMT ratio 1 month after the RSVPreF3 OA investigational vaccine dose., • SARS-CoV-2 Omicron XBB.1.5 neutralization titers against pseudovirus bearing S protein expressed as group GMT ratio 1 month after the COVID-19 mRNA vaccine.
Endpoint(s): • RSV-A and RSV-B neutralization titers expressed as GMT, MGI and SRR at 1 month after the RSVPreF3 OA investigational vaccine dose. • Percentage of participants having RSV-A and RSV-B neutralizing titers ≥ assay cut-off (i.e., LLOQ) at pre-vaccination and 1 month after the RSVPreF3 OA investigational vaccine dose., "• SARS-CoV-2 Omicron XBB.1.5 neutralization titers against pseudovirus bearing S protein expressed as GMT and MGI at 1 month after the COVID-19 mRNA vaccine. • Percentage of participants having SARS-CoV-2 Omicron XBB.1.5 neutralization titers ≥ assay cut-off (i.e., LLOQ) at pre-vaccination and 1 month after the COVID-19 mRNA vaccine dose.", "• Percentage of participants reporting each solicited administration site event and systemic event within 4 days post study intervention administration (i.e., the day of vaccination and 3 subsequent days). • Percentage of participants reporting unsolicited AEs within 30 days post study intervention administration (i.e., the day of vaccination and 29 subsequent days).", "• Percentage of participants reporting SAEs after study intervention administration (Day 1) up to study end (6 months after last study intervention administration). • Percentage of participants reporting pIMDs after study intervention administration (Day 1) up to study end (6 months after last study intervention administration). "

Source: https://euclinicaltrials.eu/ctis-public/view/2023-510196-59-00